EU clinical trial 2024-519025-37-00: An open-label safety and tolerability clinical trial of PST-611 in dry age-related macular degeneration.
Protocol code: PST-611-CT1
Sponsor: PulseSight Therapeutics (Pharmaceutical company). Phase: Human Pharmacology (Phase I)- First administration to humans. Countries: France (ongoing, recruitment ended).
Therapeutic area(s): Diseases [C] - Eye Diseases [C11]
Gender: Female, Male. Age: 18-64 years, 65+ years. Enrolment: 12.
Status: Ongoing, recruitment ended. Start date (EU): 2025-06-19. Decision date: 2025-05-12. Results received: No. Last updated: 2026-03-31.

Condition(s): Dry age-related macular degeneration.

Source: https://euclinicaltrials.eu/ctis-public/view/2024-519025-37-00